EU clinical trial 2022-502209-13-01: Safety and tolerability of CTH120, first-in-human phase I study encompassing three parts: Single and Multiple Ascending doses and potential Food Interaction
Protocol code: CTH-CTH120-FIH-01
Sponsor: Connecta Therapeutics S.L. (Pharmaceutical company). Phase: Human Pharmacology (Phase I)- First administration to humans. Countries: Spain (ended).
Therapeutic area(s): Diseases [C] - Congenital, Hereditary, and Neonatal Diseases and Abnormalities [C16]
Gender: Female, Male. Age: 18-64 years. Enrolment: 68.
Status: Ended. Start date (EU): 2023-06-23. End date (EU): 2024-11-11. Decision date: 2023-05-17. Results received: No. Last updated: 2024-02-29.

Condition(s): Fragile X syndrome

Source: https://euclinicaltrials.eu/ctis-public/view/2022-502209-13-01